EU clinical trial 2024-513704-34-00: Phase III, randomized, double-blind, placebo-controlled, multicenter study to evaluate the efficacy of pre-surgical HPV9-valente vaccination in women treated with loop electrosurgical excision (LEEP) for high-grade cervical intraepithelial neoplasia (CIN2+) up to cervical cancer initially invasive (FIGO IA1) - HOPE 9 STUDY
Protocol code: HOPE 9 STUDY
Sponsor: Azienda Unita Sanitaria Locale Toscana Nord Ovest (Hospital/Clinic/Other health care facility). Phase: Therapeutic confirmatory (Phase III). Countries: Italy (ended).
Therapeutic area(s): Diseases [C] - Neoplasms [C04]
Gender: Female. Age: 18-64 years, 65+ years. Enrolment: 1220.
Status: Ended. Start date (EU): 2021-10-01. End date (EU): 2025-12-15. Decision date: 2024-06-24. Results received: No. Last updated: 2024-06-24.

Condition(s): cervical cancer
Product: Gardasil 9 suspension for injection. Human Papillomavirus 9-valent Vaccine (Recombinant, adsorbed), WATER FOR INJECTION

Primary endpoint: evaluation of the reduction of disease recurrence (cervical intraepithelial neoplasia up to microinvasive cervical cancer) by comparing the number of recurrences in the two arms.
Endpoint(s): Analysis of the impact of the vaccine on prevalent post-surgery infections by comparing the prevalence of persistent HPV infections (duration greater than 12 months after surgery) in the two arms., Analysis of the impact of the vaccine in the post-surgical surveillance times, comparison of the viral wash-out times (negativity of the HPV test), times of negativization of the pap test and of the colposcopic exam in the post-operative period: comparison of the overexposed times of negativization in the two arms.

Source: https://euclinicaltrials.eu/ctis-public/view/2024-513704-34-00